EU clinical trial 2025-522189-60-00: Cityview: PET-Based Imaging to Evaluate the Distribution of Radiolabeled CIT-013 in Patients with Inflammatory Mediated Immune Disease
Protocol code: Cityview
Sponsor: Citryll B.V. (Pharmaceutical company). Phase: Therapeutic exploratory (Phase II). Countries: Netherlands (authorised, recruiting).
Therapeutic area(s): Diseases [C] - Immune System Diseases [C20]
Gender: Female, Male. Age: 18-64 years, 65+ years. Enrolment: 12.
Status: Authorised, recruiting. Start date (EU): 2025-11-04. Decision date: 2025-10-24. Results received: No. Last updated: 2026-06-29.

Condition(s): Inflammatory mediated immune diseases
Product: [89Zr]Zr-DFO-CIT-013

Primary endpoint: This objective is measured by whole body PET-CT imaging 24 hours (D2) after IP administration. In addition to visual assessment, uptake of [89Zr]-DFO-CIT-013 will be quantified per organ(-system). In vivo distribution profiles will be evaluated per cohort to determine ranges of uptake per organ(-system) and between cohorts to compare uptake in different IMIDs.
Endpoint(s): Frequency and severity of treatment-emergent adverse events (TEAE) throughout the trial period, including clinically relevant findings and ADAs., Pharmacokinetic (PK) levels throughout the trial, per cohort.

Source: https://euclinicaltrials.eu/ctis-public/view/2025-522189-60-00